EU clinical trial 2024-517553-26-00: A Phase 3 Study of the Selective Anaplastic Lymphoma Kinase (ALK) Inhibitor NVL-655 Compared to Alectinib in First-Line Treatment of Patients With ALK-Positive Advanced Non-Small Cell Lung Cancer (ALKAZAR)
Protocol code: NVL-655-04
Sponsor: Nuvalent Inc. (Pharmaceutical company). Phase: Therapeutic confirmatory (Phase III). Countries: Italy (ongoing, recruiting), Austria (ongoing, recruiting), France (ongoing, recruiting), Denmark (authorised, recruiting), Greece (ongoing, recruiting), Hungary (ongoing, recruiting), Poland (ongoing, recruiting), Netherlands (ongoing, recruiting), Germany (ongoing, recruiting), Portugal (ongoing, recruiting), Czechia (authorised, recruiting), Spain (ongoing, recruiting), Belgium (ongoing, recruiting).
Therapeutic area(s): Diseases [C] - Neoplasms [C04]
Gender: Female, Male. Age: 18-64 years, 65+ years. Enrolment: 291.
Start date (EU): 2025-11-12. Decision date: 2025-06-02. Results received: No. Last updated: 2026-07-15.
Decision dates by country: DE: 2025-06-04, AT: 2025-06-05, ES: 2025-06-05, PL: 2025-06-08, NL: 2025-06-04, CZ: 2025-06-05, BE: 2025-06-02, PT: 2025-06-03, FR: 2025-06-10, HU: 2025-06-04, DK: 2025-06-03, GR: 2025-06-04, IT: 2025-06-03

Condition(s): Advanced ALK-positive non-small cell lung cancer (NSCLC)
Product: NVL-655, Alecensa 150 mg hard capsules, NVL-655, Alecensa 150 mg hard capsules

Primary endpoint: Progression-free survival (PFS)
Endpoint(s): 1) - Overall survival (OS) - Progression-free survival (PFS) per investigator assessment - Time to intracranial progression per blinded independent central review (BICR) - Intracranial objective response rate (IC-ORR) - Intracranial duration of response (IC-DOR) - Objective response rate (ORR) - Duration of response (DOR) - Time to intracranial progression, IC-ORR, IC-DOR, ORR, and DOR, 2) Incidence and severity of treatment-emergent adverse events (TEAEs) and changes in clinically relevant laboratory parameters, 3) Changes in patient-reported outcomes (PROs)

Source: https://euclinicaltrials.eu/ctis-public/view/2024-517553-26-00